EU clinical trial 2023-508561-33-00: A phase I/II trial of TG4050, an individualised gene therapy, in patients with advanced cancer of the head and neck.
Protocol code: TG4050.02
Sponsor: Transgene (Pharmaceutical company). Phase: Phase I and Phase II (Integrated)- First administration to humans. Countries: France (ongoing, recruiting), Spain (ongoing, recruiting).
Therapeutic area(s): Diseases [C] - Neoplasms [C04]
Gender: Female, Male. Age: 18-64 years, 65+ years. Enrolment: 98.
Status: Ongoing, recruiting. Start date (EU): 2019-12-12. Decision date: 2023-12-06. Results received: No. Last updated: 2026-05-19.
Decision dates by country: FR: 2023-12-06, ES: 2024-08-12

Condition(s): Newly diagnosed, stage III or IV amenable to surgery, HPV negative, squamous-cell carcinoma of the oral cavity, oropharynx, hypopharynx or larynx (SCCHN) for patients who have completed and a documented complete response to gross total resection of the primary tumor and standard adjuvant therapy.

Source: https://euclinicaltrials.eu/ctis-public/view/2023-508561-33-00